EU clinical trial 2024-514025-30-00: RETINO 2018: conservative treatment for retinoblastoma: efficacy of the new management strategies and visual outcome
Protocol code: IC 2019-05
Sponsor: Institut Curie (Hospital/Clinic/Other health care facility). Phase: Therapeutic exploratory (Phase II). Countries: France (ongoing, recruiting).
Therapeutic area(s): Diseases [C] - Neoplasms [C04]
Gender: Female, Male. Age: 0-17 years. Enrolment: 225.
Status: Ongoing, recruiting. Start date (EU): 2021-03-25. Decision date: 2024-05-31. Results received: No. Last updated: 2024-05-31.

Condition(s): Ocular conservative treatment for retinoblastoma
Product: TOPOTECANE ACCORD 1 mg/ml, solution à diluer pour perfusion, VINCRISTINE HOSPIRA 2 mg/2 ml, solution injectable, Etoposide 20 mg/ml concentrate for solution for infusion, CARBOPLATINE HOSPIRA 10 mg/ml, solution injectable pour perfusion, MELPHALAN TILLOMED 50 mg/10 mL, poudre et solvant pour solution injectable / pour perfusion, Topotecan Hospira 4 mg/4 ml concentrate for solution for infusion

Primary endpoint: Study 1: Rate of eye preservation in the investigational arm (Topotecan + Melphalan) and in the reference arm (Melphalan) 24 months after the date of randomization., Study 2: Percentage of patients with major, mild or no impairment of visual function according to WHO criteria, i.e. normal bilateral visual acuity (≥ 6/10) or mild bilateral visual impairment (3/10 to 5/10) according to tumor location and extension, when the patient will have 6 years of age and at least 24 months of follow-up after study inclusion.

Source: https://euclinicaltrials.eu/ctis-public/view/2024-514025-30-00